EU clinical trial 2023-505871-63-00: A PHASE 3 RANDOMIZED, OPEN-LABEL STUDY OF OP-1250 MONOTHERAPY VS STANDARD OF CARE FOR THE TREATMENT OF ER+, HER2- ADVANCED OR METASTATIC BREAST CANCER FOLLOWING ENDOCRINE AND CDK4/6 INHIBITOR THERAPY (OPERA-01)
Protocol code: OP-1250-301
Sponsor: Olema Pharmaceuticals Inc. (Pharmaceutical company). Phase: Therapeutic confirmatory (Phase III). Countries: Italy (ongoing, recruitment ended), Bulgaria (ongoing, recruitment ended), Belgium (ongoing, recruitment ended), Austria (ongoing, recruitment ended), Romania (ongoing, recruitment ended), Germany (ongoing, recruitment ended), Czechia (ongoing, recruitment ended), Netherlands (ongoing, recruitment ended), France (ongoing, recruitment ended), Portugal (ongoing, recruitment ended), Poland (ongoing, recruitment ended), Hungary (ongoing, recruitment ended), Spain (ongoing, recruitment ended).
Therapeutic area(s): Diseases [C] - Cardiovascular Diseases [C14]; Phenomena and Processes [G] - Metabolism [G03]; Phenomena and Processes [G] - Physiological processes [G07]
Gender: Female, Male. Age: 18-64 years, 65+ years. Enrolment: 382.
Status: Ongoing, recruitment ended. Start date (EU): 2024-04-08. Decision date: 2024-03-25. Results received: No. Last updated: 2026-03-16.
Decision dates by country: BE: 2024-03-28, BG: 2024-03-28, NL: 2024-03-26, ES: 2024-04-12, HU: 2024-04-02, AT: 2024-04-02, PT: 2024-03-27, IT: 2024-03-27, DE: 2024-03-26, FR: 2024-03-28, CZ: 2024-03-25, PL: 2024-04-02, RO: 2024-03-28

Condition(s): ER+, HER2- metastatic breast cancer following endocrine and CDK 4/6 inhibitor therapy
Product: Palazestrant, FULVESTRANT, Palazestrant, EXEMESTANE, GOSERELIN, LETROZOLE, Palazestrant, ANASTROZOLE, Palazestrant

Primary endpoint: 1. Safety and tolerability, assessed by AEs, SAEs, dose modifications, clinical laboratory parameters (ie, hematology, chemistry, and coagulation), ECGs, and vital signs measurements 2. BIRC-assessed PFS
Endpoint(s): 1. Local investigator-assessed ORR, DoR, DCR, CBR, and PFS 2. Plasma levels of OP-1250 at predefined intervals to establish PK parameters (including: Cmax, Cmin, Tmax, AUC, and OP-1250 trough concentration at steady state) 3. Overall Survival 4. BIRC-assessed PFS 5. Overall survival, 6. Local investigator-assessed PFS 7. BIRC-assessed ORR 8. BIRC-assessed DoR 9. BIRC-assessed CBR 10. Local investigator-assessed ORR 11. Local investigator-assessed DoR 12. Local investigator-assessed CBR 13. Safety and tolerability, assessed by AEs, SAEs, dose modifications, clinical laboratory parameters (ie, hematology, chemistry, and coagulation), ECGs, performance status, and vital sign measurements, 14. Plasma levels of palazestrant at predefined intervals to establish PK parameters (including: Cmax, Cmin, Tmax, AUC, t1/2, and palazestrant trough concentration at steady state) 15. PRO endpoints, assessed using the EORTC-QLQ-C30 and EQ-5D-5L questionnaires

Source: https://euclinicaltrials.eu/ctis-public/view/2023-505871-63-00